EU clinical trial 2024-511637-35-00: Prephase treatment with prednisone +/- Vitamin D supplementation followed by immunochemotherapy in Elderly patients with Diffuse Large B-Cell Lymphoma (DLBCL). A randomized, open label, phase III study by Fondazione Italiana Linfomi.
Sponsor: Fondazione Italiana Linfomi Ets (Patient organisation/association). Phase: Therapeutic confirmatory (Phase III). Countries: Italy (ongoing, recruitment ended).
Therapeutic area(s): Diseases [C] - Hemic and Lymphatic Diseases [C15]
Gender: Female, Male. Age: 65+ years. Enrolment: 430.
Status: Ongoing, recruitment ended. Start date (EU): 2021-03-23. Decision date: 2024-11-18. Results received: No. Last updated: 2024-11-18.

Condition(s): Elderly patients with Diffuse Large B-Cell Lymphoma (DLBCL)
Product: COLECALCIFEROL, PREDNISONE

Primary endpoint: Progression-Free Survival (PFS).
Endpoint(s): Overall Survival (OS)., Event Free Survival (EFS)., Response rate (ORR, CRR; Cheson 2014)., Early death rate (EDR): all deaths recorded within 90 days from the date of diagnosis., AEs rate (CTCAE current version)., Rate of ECOG changes after prephase., Rate of 25(OH)VitD correction (VitD supplementation arm): number of patients with 25(OH)VitD levels above or equal 20ng/ml at day 1 of cycle 2., Rate of patients who maintain 25(OH)VitD levels in the normal range at EOI., PROs endpoints include: time-to-deterioration in EORTC QLQ-C30 physical functioning and fatigue and FACT-Lym-LymS; proportion of patients in each arm achieving meaningful improvement in EORTC-QLQ-C30 physical functioning and fatigue, and FACT-Lym-LymS; and a comparison of EORTC-QLQ-C30 treatment-related symptoms between the two treatment arms.

Source: https://euclinicaltrials.eu/ctis-public/view/2024-511637-35-00